EU clinical trial 2024-517970-35-00: First-line immunotherapy using Wilms’ tumor protein 1 (WT1)-targeted dendritic cell vaccinations for malignant pleural mesothelioma
Protocol code: MESODEC
Sponsor: Antwerp University Hospital (Hospital/Clinic/Other health care facility). Phase: Therapeutic exploratory (Phase II). Countries: Belgium (ended).
Therapeutic area(s): Diseases [C] - Respiratory Tract Diseases [C08]; Diseases [C] - Neoplasms [C04]; Analytical, Diagnostic and Therapeutic Techniques and Equipment [E] - Therapeutics [E02]; Phenomena and Processes [G] - Immune system processes [G12]
Gender: Female, Male. Age: 18-64 years, 65+ years. Enrolment: 30.
Status: Ended. Start date (EU): 2017-10-03. End date (EU): 2025-03-09. Decision date: 2024-11-04. Results received: Yes. Last updated: 2025-01-20.
Decision dates by country: BE: 2024-12-16

Condition(s): Malignant Pleural Mesothelioma
Product: WT1 LAMP mRNA DC

Primary endpoint: Safety will be assessed by clinical laboratory tests and adverse event reporting: (1) Microbiological testing (bacteria, fungi, mycoplasma, endotoxin) will be performed to assess safe DC vaccine production, (2) Local toxicity (e.g. skin reactions at injection site) will be reported, (3) Systemic toxicity will be scored according to the latest version of the National Cancer Institute’s Common Terminology Criteria for Adverse Events (CTCAE) and Common Toxicity Criteria (CTC), Feasibility will be assessed based on the success of (1) leukapheresis and (2) DC vaccine preparation (production of at least 4 DC vaccines) and (3) administration of combined chemoimmunotherapy cycles within the proposed time schedule
Endpoint(s): Clinical endpoints: time to progression (TTP), progression-free survival (PFS) and overal survival (OS) (Tumor assessment will be performed according to the latest modified Response Evaluation Criteria In Solid Tumors (RECIST), PET Response Criteria In Solid Tumors (PERCIST) and endpoints for cancer immunotherapy trials), Translational endpoint: immunological responses (Systemic and local immunological response analysis will be performed to determine the in vivo immunogenicity of WT1 mRNA-electroporated DC vaccinations when combined with chemotherapy for the frontline treatment of MPM by evaluating the development of effective anti-mesothelioma immunity)

Source: https://euclinicaltrials.eu/ctis-public/view/2024-517970-35-00